EU clinical trial 2025-523121-17-00: Multicenter clinical trial on the effectiveness and safety of outpatient treatment of acute uncomplicated diverticulitis without antibiotics versus antibiotic treatment. ADIANA Trial.
Protocol code: IMIB-ADI-2025-01
Sponsor: Fundacion Para La Formacion E Investigacion Sanitaria De La Region De Murcia (Educational Institution). Phase: Therapeutic use (Phase IV). Countries: Spain (ongoing, recruiting).
Therapeutic area(s): Diseases [C] - Digestive System Diseases [C06]
Gender: Female, Male. Age: 18-64 years, 65+ years. Enrolment: 282.
Status: Ongoing, recruiting. Start date (EU): 2026-05-29. Decision date: 2026-04-30. Results received: No. Last updated: 2026-06-16.
Decision dates by country: ES: 2026-05-29

Condition(s): Diverticular disease of the intestine,
Product: cefuroxima cinfa 250 mg comprimidos recubiertos con película EFG, Metronidazol Normon 250 mg comprimidos EFG, ciprofloxacino cinfa 500 mg comprimidos recubiertos EFG, MEIACT 200 mg comprimidos recubiertos con película, ciprofloxacino cinfa 750 mg comprimidos recubiertos EFG, amoxicilina/ácido clavulánico cinfa 875 mg/125 mg comprimidos recubiertos con película EFG

Primary endpoint: Therapeutic failure rate (early, within ≤48 hours, and at one month) for both treatments (with and without antibiotics).
Endpoint(s): Results in terms of recurrence (number, type, and time to onset)., Time (days) until clinical recovery and return to daily social and work life., Risk factors for the development of diverticulitis and prognostic factors predictive of therapeutic failure and unfavorable progression to complicated acute diverticulitis, in general and according to treatment group, Quality of life and level of satisfaction with the care received in both groups

Source: https://euclinicaltrials.eu/ctis-public/view/2025-523121-17-00